EU clinical trial 2025-523356-31-01: Comparison of low versus intermediate intravenous dexamethasone doses on rebound pain after ambulatory open foot surgery under popliteal sciatic nerve block: a double-blind clinical trial.
Protocol code: DexaRP
Sponsor: Hospital Universitario Dr Peset Aleixandre (Hospital/Clinic/Other health care facility). Phase: Phase III and phase IV (Integrated). Countries: Spain (authorised, recruitment pending).
Therapeutic area(s): Analytical, Diagnostic and Therapeutic Techniques and Equipment [E] - Anesthesia and Analgesia [E03]
Gender: Female, Male. Age: 18-64 years, 65+ years. Enrolment: 180.
Status: Authorised, recruitment pending. Decision date: 2025-12-10. Results received: No. Last updated: 2025-12-10.

Condition(s): Postoperative pain, Rebound pain after regional anaesthesia
Product: Dexametasona Kern Pharma 4 mg/ml solución inyectable EFG

Primary endpoint: Incidence of rebound pain, defined as a score ≥7 on the Numerical Rating Scale (NRS) following recovery of sensory function after the sciatic nerve block. The NRS (0 = no pain; 10 = worst pain imaginable) will be assessed at 24, 48, and 72 hours postoperatively via telephone follow-up. Patients will be previously instructed on how to use the scale.
Endpoint(s): Time to Onset of Postoperative Pain: Defined as the time interval between the confirmed establishment of the sciatic nerve block and the first perception of pain at the surgical site. This outcome will be assessed through telephone follow-up calls at 24 hours, 48 hours, and, if necessary, 72 hours after the block (for outpatient surgery) to record the timing of pain onset and estimate the duration of sensory block., Adverse Events Related to Dexamethasone: Significant hyperglycemia (>180 mg/dl), defined by capillary blood glucose measurement prior to discharge. Surgical site infection or delayed wound healing, monitored during follow-up for up to 1 month postoperatively.

Source: https://euclinicaltrials.eu/ctis-public/view/2025-523356-31-01